EU clinical trial 2025-521866-92-01: SON4PEM study: Sonlicromanol in post-COVID: A randomized, double-blind, placebo-controlled, phase II trial
Sponsor: Amsterdam UMC Stichting (Patient organisation/association). Phase: Therapeutic exploratory (Phase II). Countries: Netherlands (ongoing, recruiting).
Therapeutic area(s): Diseases [C] - Virus Diseases [C02]; Diseases [C] - Nutritional and Metabolic Diseases [C18]
Gender: Female, Male. Age: 18-64 years. Enrolment: 80.
Status: Ongoing, recruiting. Start date (EU): 2025-12-12. Decision date: 2025-12-02. Results received: No. Last updated: 2026-07-21.
Decision dates by country: NL: 2026-02-04

Condition(s): long COVID
Product: Sonlicromanol, Sonlicromanol tablets Placebo

Primary endpoint: Fatigue symptoms measured at week 13 by the FAS
Endpoint(s): Secondary endpoints include improvement in various disease domains within long COVID on week 4, 8 and 13 using the SF-36 and the PROMIS cognitive function 8a score. In addition, physical improvement will be measured using the Repeated Handgrip Strength and the Amsterdam Cognition Scan on baseline and week 4, 8 and 13.

Source: https://euclinicaltrials.eu/ctis-public/view/2025-521866-92-01